EU clinical trial 2024-518225-15-00: A Phase 2 Open-Label Study to Evaluate Momelotinib in combination with Luspatercept in Participants with Transfusion Dependent Primary or Secondary Myelofibrosis
Protocol code: 220752
Sponsor: Glaxosmithkline Research & Development Limited (Pharmaceutical company). Phase: Therapeutic exploratory (Phase II). Countries: France (authorised, recruitment pending), Italy (authorised, recruitment pending), Germany (authorised, recruitment pending), Spain (authorised, recruitment pending).
Therapeutic area(s): Diseases [C] - Hemic and Lymphatic Diseases [C15]
Gender: Female, Male. Age: 18-64 years, 65+ years. Enrolment: 51.
Status: Authorised, recruitment pending. Decision date: 2025-03-25. Results received: No. Last updated: 2026-05-26.
Decision dates by country: DE: 2025-03-26, ES: 2025-03-25, IT: 2025-03-27, FR: 2025-03-31

Condition(s): Myelofibrosis
Product: Reblozyl 75 mg powder for solution for injection

Primary endpoint: Proportion of participants with TI by the end of Week 24; defined as not requiring RBC transfusion (except in the case of clinically overt bleeding) for any ≥12-week interval.
Endpoint(s): Incidences of AEs, SAEs, and AEs leading to discontinuation., Clinically important changes in laboratory parameters (hematology, chemistry), vital signs, and ECOG performance status., Proportion of participants with TI at the end of Week 24; defined as not requiring RBC transfusion (except in the case of clinically overt bleeding) for ≥12 weeks preceding week 24, with all Hgb levels during the ≥12-week interval of ≥8 g/dL (except in the case of clinically overt bleeding)., Plasma concentration of Momelotinib and M21.

Source: https://euclinicaltrials.eu/ctis-public/view/2024-518225-15-00